EU clinical trial 2024-514424-16-00: Regorafenib in combination with temozolomide with or without radiotherapy in patients with newly diagnosed MGMT-Methylated, IDH wild-type glioblastoma. A phase I dose-finding study (REGOMA-2).
Protocol code: REGOMA-2
Sponsor: Istituto Oncologico Veneto (Hospital/Clinic/Other health care facility). Phase: Human Pharmacology (Phase I)- Other. Countries: Italy (ended).
Therapeutic area(s): Diseases [C] - Nervous System Diseases [C10]
Gender: Female, Male. Age: 18-64 years, 65+ years. Enrolment: 36.
Status: Ended. Start date (EU): 2022-07-04. End date (EU): 2025-12-22. Decision date: 2025-01-27. Results received: No. Last updated: 2025-12-05.

Condition(s): MGMT-Methylated, IDH wild-type glioblastoma

Source: https://euclinicaltrials.eu/ctis-public/view/2024-514424-16-00